EU clinical trial 2023-503230-49-00: A Phase 3, Open-label Study Evaluating the Pharmacokinetics, Safety, and Tolerability of Elexacaftor/Tezacaftor/Ivacaftor in Cystic Fibrosis Subjects 12 to Less Than 24 Months of Age
Protocol code: VX22-445-122
Sponsor: Vertex Pharmaceuticals Inc. (Pharmaceutical company). Phase: Therapeutic confirmatory (Phase III). Countries: Germany (ended), Netherlands (ended), Denmark (ended).
Therapeutic area(s): Diseases [C] - Respiratory Tract Diseases [C08]
Gender: Female, Male. Age: 0-17 years. Enrolment: 15.
Status: Ended. Start date (EU): 2024-07-16. End date (EU): 2025-09-01. End date: 2025-09-04. Decision date: 2024-01-24. Results received: Yes. Last updated: 2025-08-19.
Decision dates by country: DK: 2024-05-07, DE: 2024-01-24, NL: 2024-05-07

Condition(s): Cystic Fibrosis
Product: VX-770 granules, VX-445/VX-661/VX-770 fixed-dose combination granules, VX-445/VX-661/VX-770 granules, Kalydeco 25 mg granules in sachet, VX-445/VX-661/VX-770 granules, Kalydeco 50 mg granules in sachet

Primary endpoint: Safety and tolerability assessments as determined by AEs, clinical laboratory values, standard 12-lead ECGs, vital signs, and pulse oximetry
Endpoint(s): PK parameters of ELX, TEZ, IVA, and relevant metabolites, Absolute change in sweat chloride (SwCl) from baseline through Week 24

Source: https://euclinicaltrials.eu/ctis-public/view/2023-503230-49-00